EU clinical trial 2023-504308-27-00: BEAMION Lung-2: A Phase III, open-label, randomized, activecontrolled, multi-centre trial evaluating orally administered zongertinib (BI 1810631) compared with standard of care as first-line treatment in patients with unresectable, locally advanced or metastatic nonsquamous non-small cell lung cancer harbouring HER2 tyrosine kinase domain mutations
Protocol code: 1479-0008
Sponsor: Boehringer Ingelheim International GmbH, Boehringer Ingelheim Espana S.A. (Industry, Pharmaceutical company). Phase: Therapeutic confirmatory (Phase III). Countries: Belgium (ongoing, recruitment ended), Sweden (ongoing, recruitment ended), Italy (ongoing, recruitment ended), Netherlands (ongoing, recruitment ended), France (ongoing, recruitment ended), Portugal (ongoing, recruitment ended), Norway (ongoing, recruitment ended), Germany (ongoing, recruitment ended), Spain (ongoing, recruitment ended), Poland (ongoing, recruitment ended), Greece (ended), Austria (ongoing, recruitment ended), Hungary (not authorised).
Therapeutic area(s): Diseases [C] - Neoplasms [C04]
Gender: Female, Male. Age: 18-64 years, 65+ years. Enrolment: 121.
Start date (EU): 2024-06-06. Decision date: 2024-03-05. Results received: No. Last updated: 2026-06-19.
Decision dates by country: HU: 2024-03-06, GR: 2024-06-05, BE: 2024-03-08, ES: 2024-05-31, DE: 2024-06-03, PL: 2024-06-05, AT: 2024-05-31, SE: 2024-03-11, PT: 2024-06-03, NL: 2024-03-07, FR: 2024-05-31, IT: 2024-03-11, NO: 2024-03-08

Condition(s): non-squamous non-small cell lung cancer
Product: Carboplatin Hikma 10 mg/ml Konzentrat zur Herstellung einer Infusionslösung, ALIMTA 500 mg powder for concentrate for solution for infusion, Cisplatin Hikma 1 mg/ml Konzentrat zur Herstellung einer Infusionslösung, BI 1810631, KEYTRUDA 25 mg/mL concentrate for solution for infusion

Primary endpoint: The primary endpoint is PFS according to RECIST 1.1 determined by blinded central independent review.
Endpoint(s): The key secondary endpoints are OR according to RECIST 1.1, determined by blinded central independent review, the change from baseline to Week 25 of NSCLC-SAQ total score, and OS., Duration of response (DoR), determined by blinded central independent review., Progression free survival, determined by blinded central independent review., Bi-compartmental PFS, determined by blinded central independent review., Overall response, determined by blinded central independent review., Further patient reported outcomes (PROs) from NSCLC-SAQ and EORTC QLQ-C30 domain scores, analyzed as change from baseline to Week 25, Occurrence of AEs during the on-treatment period, graded according to CTCAE version 5.0., Occurrence of serious AEs (SAEs) during the on-treatment period, graded according to CTCAE version 5.0.

Source: https://euclinicaltrials.eu/ctis-public/view/2023-504308-27-00